EU clinical trial 2025-523355-59-00: A Phase 1, Randomized, Double-Blind, Two-Arm, Two-Way Crossover Study of Pharmacokinetics and Pharmacodynamics of QL0911
Protocol code: QL0911-102
Sponsor: Qilu Pharmaceutical Co. Ltd. (Pharmaceutical company). Phase: Human Pharmacology (Phase I)- Bioequivalence Study. Countries: Poland (authorised, recruitment pending).
Therapeutic area(s): Diseases [C] - Hemic and Lymphatic Diseases [C15]
Gender: Female, Male. Age: 18-64 years. Enrolment: 76.
Status: Authorised, recruitment pending. Decision date: 2026-01-26. Results received: No. Last updated: 2026-07-06.

Condition(s): Immune Thrombocytopenia, Hematopoietic Syndrome of Acute Radiation Syndrome

Source: https://euclinicaltrials.eu/ctis-public/view/2025-523355-59-00